EU clinical trial 2022-502926-42-00: A Single Ascending Dose Study to Assess the Safety, Tolerability, and Pharmacokinetics of MK-3508 in Healthy Participants
Protocol code: MK-3508-001
Sponsor: Merck Sharp & Dohme LLC (Pharmaceutical company). Phase: Human Pharmacology (Phase I)- First administration to humans. Countries: Belgium (ended).
Therapeutic area(s): Diseases [C] - Virus Diseases [C02]
Gender: Male. Age: 18-64 years. Enrolment: 32.
Status: Ended. Start date (EU): 2023-03-30. End date (EU): 2024-03-15. End date: 2024-03-16. Decision date: 2023-03-13. Results received: No. Last updated: 2023-12-14.
Decision dates by country: BE: 2023-03-30

Condition(s): Respiratory syncytial virus infection

Source: https://euclinicaltrials.eu/ctis-public/view/2022-502926-42-00